EU clinical trial 2023-504198-19-00: A Randomized, Double-Blind, Placebo-Controlled, Phase 3 Study to Evaluate the Safety and Efficacy of Fazirsiran in the Treatment of Alpha-1 Antitrypsin Deficiency-Associated Liver Disease With METAVIR Stage F1 Fibrosis
Protocol code: TAK-999-3002
Sponsor: Takeda Development Center Americas Inc. (Pharmaceutical company). Phase: Therapeutic confirmatory (Phase III). Countries: Austria (authorised, recruiting), Ireland (authorised, recruiting), Sweden (ongoing, recruiting), Spain (authorised, recruiting), Italy (ongoing, recruiting), Belgium (ongoing, recruiting), Germany (ongoing, recruiting), Poland (ended), Portugal (ongoing, recruiting), France (ongoing, recruiting).
Therapeutic area(s): Diseases [C] - Nutritional and Metabolic Diseases [C18]
Gender: Female, Male. Age: 18-64 years, 65+ years. Enrolment: 25.
Start date (EU): 2024-04-18. Decision date: 2024-03-27. Results received: No. Last updated: 2026-05-21.
Decision dates by country: FR: 2024-03-28, AT: 2024-09-22, IE: 2024-03-28, BE: 2024-03-28, PL: 2024-04-02, ES: 2024-03-27, IT: 2024-03-28, DE: 2024-04-03, PT: 2024-04-01, SE: 2024-04-02

Condition(s): Alpha-1 Antitrypsin Deficiency-Associated Liver Disease
Product: SALINE, Fazirsiran

Primary endpoint: AEs and SAE including any pulmonary AEs or SAEs indicative of worsening pulmonary condition/function (eg, pulmonary exacerbation, respiratory infection, significant PFT decline)., Change from baseline over time to EOS in pulmonary function parameters at scheduled visits, Change from baseline in whole lung 15th percentile density as measured by computed tomography (CT) lung densitometry over time to Week 100., Vital signs., ECG measurements., Clinical laboratory values (hematology, biochemistry including liver tests, coagulation, and urinalysis results).
Endpoint(s): Change from baseline in serum Z-AAT protein over time to Week 106., Percent change from baseline in intrahepatic liver Z-AAT protein at Week 106., Change from baseline in intrahepatic Z-AAT protein polymer burden assessed by PAS+D staining at Week 106., No change or decrease from baseline in intrahepatic Z-AAT protein polymer burden assessed by PAS+D staining at Week 106., Change from baseline in intrahepatic portal inflammation at Week 106., No change or decrease from baseline in intrahepatic portal inflammation at Week 106., No change or decrease from baseline in histologic fibrosis score (METAVIR staging) at Week 106., Change from baseline in VCTE-derived liver stiffness over time to Week 106., Change from baseline in markers of liver injury (alanine aminotransferase [ALT], aspartate aminotransferase [AST], γ-glutamyl transferase [GGT]) over time to Week 106.

Source: https://euclinicaltrials.eu/ctis-public/view/2023-504198-19-00